EU clinical trial 2023-506598-36-00: SCARR : « Allogenic Umbilical Cord Mesenchymal Stromal Cells for the treatment of chronic renal (cABMR) graft rejection »
Sponsor: Assistance Publique Hopitaux De Paris (Hospital/Clinic/Other health care facility). Phase: Phase II and Phase III (Integrated). Countries: France (authorised, recruitment pending).
Therapeutic area(s): Diseases [C] - Immune System Diseases [C20]
Gender: Female, Male. Age: 18-64 years, 65+ years. Enrolment: 22.
Status: Authorised, recruitment pending. Decision date: 2025-02-18. Results received: No. Last updated: 2025-08-01.

Condition(s): Adult Patients kidney transplant recipients who have developed chronic humoral rejection, diagnosed through a kidney biopsy (Banff 2017 Classification), resistant to conventional treatment (3 injections at one-month intervals of 2g/kg of IVIG)
Product: Solution de chlorure de sodium à 0,9%, Allogeneic umbilical cord derived MSC (thawed and washed)

Primary endpoint: Change in renal function (estimated glomerular filtration rate CDK-EPI) (eGFR) between D0 and M24
Endpoint(s): Safety of UC-MSC injection (after injection for 4 hours): Measurement of pulsed oxygen saturation, dyspnea, blood pressure, eGFR, CRP, cellular infiltration (BANFF 2017 criteria for the evaluation of acute rejection), Variation in renal function (eGFR) on D0, M1, and respectively M2, M6, and M12, M18 and M24, Cumulative incidence of patients requiring dialysis at 12 and 24 months., Evolution of 24-hour proteinuria and the proteinuria/creatininuria ratio between D0 and M1, M2, M6 and M12, M18 and M24, Luminex assay for donor-specific anti-HLA antibodies (single antigen) on D0, M2, M6, M12, M24, Quantification of Interstitial Fibrosis and Tubular Atrophy, glomerulitis, and capillaritis on histological section. Quantification of fibrosis by Syrius Red and immunohistochemistry at 6 months, T and B lymphocyte phenotyping (% of T and B regs) on D0, M2, M6

Source: https://euclinicaltrials.eu/ctis-public/view/2023-506598-36-00